EU clinical trial 2025-523297-16-00: Phase 1 First-in-Human Study of JNJ-95566692 in Participants with NHLs
Protocol code: 95566692LYM1001
Sponsor: Janssen Cilag International (Pharmaceutical company). Phase: Human Pharmacology (Phase I)- First administration to humans. Countries: Belgium (ongoing, recruiting), France (ongoing, recruiting), Spain (ongoing, recruiting).
Therapeutic area(s): Diseases [C] - Neoplasms [C04]
Gender: Female, Male. Age: 18-64 years, 65+ years. Enrolment: 65.
Status: Ongoing, recruiting. Start date (EU): 2026-02-27. Decision date: 2026-02-26. Results received: No. Last updated: 2026-06-04.
Decision dates by country: BE: 2026-02-26, FR: 2026-05-21, ES: 2026-06-04

Condition(s): Non-Hodgkin Lymphoid Malignancies (NHLs)

Source: https://euclinicaltrials.eu/ctis-public/view/2025-523297-16-00